EU clinical trial 2024-516900-41-00: A First-in-human, Phase 1/2, Multicenter, Open-label, Dose Escalation and Expansion Study to Evaluate the Safety, Pharmacokinetics, and Antitumor activity of ADCE-D01, a Humanized Anti-human uPARAP Antibody Linked to a Topoisomerase I Inhibitor, in Patients with Metastatic and/or Unresectable Soft Tissue Sarcoma
Protocol code: ADCE-D01-001
Sponsor: ADCendo ApS (Pharmaceutical company). Phase: Phase I and Phase II (Integrated)- First administration to humans. Countries: Belgium (ongoing, recruiting), Germany (ongoing, recruiting), France (ongoing, recruiting).
Therapeutic area(s): Diseases [C] - Neoplasms [C04]
Gender: Female, Male. Age: 18-64 years, 65+ years. Enrolment: 144.
Status: Ongoing, recruiting. Start date (EU): 2025-06-24. Decision date: 2025-04-29. Results received: No. Last updated: 2026-08-06.
Decision dates by country: BE: 2025-04-30, DE: 2025-04-29, FR: 2025-04-29

Condition(s): Soft Tissue Sarcoma
Product: ADCE-D01

Primary endpoint: Phase 1a (Dose Escalation) and Phase 1b (Dose Confirmation): • Incidence of dose-limiting toxicities (DLTs)., Phase 1a (Dose Escalation) and Phase 1b (Dose Confirmation): • Nature, incidence, severity and causality of treatment-emergent adverse events (TEAEs) and changes from baseline in laboratory parameters using the National Cancer Institute (NCI) Common Terminology Criteria for Adverse Events (CTCAE) version 5.0 (v5.0)., Phase 1a (Dose Escalation) and Phase 1b (Dose Confirmation): • Tolerability as assessed by TEAEs leading to dose interruption, reduction and/or discontinuation., Phase 2 (Expansion Cohorts): • ORR per RECIST v1.1 by Investigator assessment., Phase 2 (Expansion Cohorts): • PFS rate at 3 months., Phase 2 (Expansion Cohorts): • Nature, incidence, severity and causality of TEAEs and changes from baseline in laboratory parameters using the NCI CTCAE v 5.0., Phase 2 (Expansion Cohorts): • Tolerability as assessed by TEAEs leading to dose interruption, reduction and/or discontinuation.
Endpoint(s): Phase 1a (Dose Escalation) and Phase 1b (Dose Confirmation): • PK parameters including, but not limited to maximum concentration (Cmax), time to Cmax (Tmax), and area under the concentration-time curve (AUC)., Phase 1a (Dose Escalation) and Phase 1b (Dose Confirmation): • Objective response rate (ORR), duration of response (DOR), progression-free survival (PFS), clinical benefit rate (CBR), and time to response (TTR) per Response Evaluation Criteria in Solid Tumors (RECIST) version 1.1 by Investigator assessment., Phase 1a (Dose Escalation) and Phase 1b (Dose Confirmation): • overall survival (OS)., Phase 2 (Expansion Cohorts): • DOR, per RECIST v1.1 by Investigator assessment., Phase 2 (Expansion Cohorts): • PFS, CBR, and TTR, per RECIST v1.1 by Investigator assessment., Phase 2 (Expansion Cohorts): • OS.

Source: https://euclinicaltrials.eu/ctis-public/view/2024-516900-41-00